EU clinical trial 2023-506185-31-00: A randomized, double-blind, dose-ranging, placebo-controlled study to evaluate the efficacy and safety of PLN-74809 (bexotegrast) for the treatment of idiopathic pulmonary fibrosis (BEACON-IPF)
Protocol code: PLN-74809-IPF-206
Sponsor: Pliant Therapeutics Inc. (Pharmaceutical company). Phase: Phase II and Phase III (Integrated). Countries: Greece (ended), France (ended), Netherlands (ended), Italy (ended), Spain (ended), Czechia (ended), Belgium (ended), Germany (ended), Poland (ended), Denmark (ended), Portugal (ended).
Therapeutic area(s): Diseases [C] - Respiratory Tract Diseases [C08]
Gender: Female, Male. Age: 18-64 years, 65+ years. Enrolment: 318.
Status: Ended. Start date (EU): 2024-07-18. End date (EU): 2025-03-03. End date: 2025-04-04. Decision date: 2024-03-04. Results received: Yes. Last updated: 2025-03-06.
Decision dates by country: FR: 2024-03-08, DK: 2024-03-04, CZ: 2024-03-04, BE: 2024-06-03, DE: 2024-03-06, GR: 2024-03-11, IT: 2024-03-11, NL: 2024-03-04, PL: 2024-03-07, PT: 2024-05-27, ES: 2024-03-04

Condition(s): Idiopathic pulmonary fibrosis (IPF)
Product: Bexotegrast, Placebo matching PLN-74809

Primary endpoint: Change from baseline in absolute FVC (mL) at Week 52
Endpoint(s): Time to disease progression, defined as time to first occurrence of ≥10% absolute decline from baseline in forced vital capacity percent predicted (FVCpp), adjudicated respiratory-related hospitalization, adjudicated acute IPF exacerbation or all-cause mortality through Week 52, Proportion of participants with a ≥10% absolute decline in FVCpp from baseline or all-cause mortality through Week 52, Change from baseline in L-PF Dyspnoea Domain score at Week 52, Change from baseline in L-PF Cough Domain score at Week 52, Change from baseline in King’s Brief Interstitial Lung Disease (K-BILD) questionnaire Total score at Week 52, Absolute change from baseline in quantitative lung fibrosis (QLF) extent (%) at Week 52, Proportion of participants with treatment-emergent adverse events and serious adverse events, Time to disease progression, defined as time to first occurrence of adjudicated respiratory-related hospitalization, adjudicated acute IPF exacerbation or all-cause mortality through Week 52

Source: https://euclinicaltrials.eu/ctis-public/view/2023-506185-31-00